EU clinical trial 2024-515796-35-00: Phase 2, Multicentre, Randomised, Double-blind, Placebo-controlled Safety and Efficacy Study of CDR132L on Reverse Cardiac Remodelling in Participants with Heart Failure with Preserved Ejection Fraction and Left Ventricular Hypertrophy.
Protocol code: NN6706-8212
Sponsor: Novo Nordisk A/S (Pharmaceutical company). Phase: Therapeutic exploratory (Phase II). Countries: Poland (ongoing, recruiting), Germany (ongoing, recruiting), Spain (ongoing, recruiting).
Therapeutic area(s): Diseases [C] - Cardiovascular Diseases [C14]
Gender: Female, Male. Age: 18-64 years, 65+ years. Enrolment: 57.
Status: Ongoing, recruiting. Start date (EU): 2025-06-26. Decision date: 2025-05-28. Results received: No. Last updated: 2026-05-25.
Decision dates by country: DE: 2025-05-28, ES: 2025-05-30, PL: 2025-06-01

Condition(s): Heart Failure with Preserved Ejection Fraction and Left Ventricular Hypertrophy.

Primary endpoint: Change in normalised miR-132 from baseline (V2) to week 24 (V14). Unit: Ratio to baseline
Endpoint(s): Change in composite Z-score based on the 3 outcome measures LVMi (CMR), LAVi (CMR) and NT-proBNP from baseline (V2) to week 24 (V14). Unit: Score, Change in normalised miR-132 from baseline (V2) to week 24 (V14). Unit: Ratio to baseline, Number of adverse events from baseline (V2) to week 24 (V14). Unit: Count, Number of adverse events From baseline (V2) to week 60 (V27). Unit: Count

Source: https://euclinicaltrials.eu/ctis-public/view/2024-515796-35-00